EU clinical trial 2022-502968-20-02: Drug Rediscovery for rare Immune Mediated Inflammatory Diseases (DRIMID)
Protocol code: 2022-502968-20
Sponsor: University Medical Center Utrecht (Hospital/Clinic/Other health care facility). Phase: Therapeutic exploratory (Phase II). Countries: Netherlands (ongoing, recruiting).
Therapeutic area(s): Diseases [C] - Immune System Diseases [C20]
Gender: Female, Male. Age: 18-64 years. Enrolment: 40.
Status: Ongoing, recruiting. Start date (EU): 2024-05-30. Decision date: 2023-12-18. Results received: No. Last updated: 2025-12-24.

Condition(s): Behcet's disease, Idiopathic Inflammatory Myopathies
Product: Jyseleca 200 mg film-coated tablets, Jyseleca 100 mg film-coated tablets

Primary endpoint: EuroQol 5D-5L (EQ-5D-5L) form, Behçet’s Disease Current Activity Form (BDCAF), Total Improvement Score (TIS) of the International Myositis Assessment Clinical Studies (IMACS) group
Endpoint(s): AUC for number of oral ulcers, Cutaneous Dermatomyositis Disease Area and Severity index (CDASI), Total number of flares in each disease, measured by a ≥1 point increase in Physician Global Assessment (PGA) on a scale from 0-3, Visual Analogue Scale (VAS) of disease activity, based on the clinical view of the local principal investigator, Glucocorticoid Toxicity Index (GTI), Changes in glucocorticoid dose, VAS score of pain, patients perspective, Functional Assessment of Chronic Illness Therapy – Fatigue (FACIT-F), Patient Acceptable Symptom State (PASS), Exposure-adjusted incidence rates for treatment-emergent adverse events

Source: https://euclinicaltrials.eu/ctis-public/view/2022-502968-20-02